EU clinical trial 2024-513457-70-00: A Quadruple Masked, Dose-Finding Study to Evaluate the Efficacy and Safety of Intranasal BPL-003, with Open Label Extension, in Patients with Treatment Resistant Depression
Protocol code: BPL-003-201
Sponsor: Beckley Psytech Limited (Pharmaceutical company). Phase: Therapeutic exploratory (Phase II). Countries: Poland (ended), Spain (ended), Germany (ended).
Therapeutic area(s): Psychiatry and Psychology [F] - Mental Disorders [F03]
Gender: Female, Male. Age: 18-64 years, 65+ years. Enrolment: 87.
Status: Ended. Start date (EU): 2023-09-08. End date (EU): 2025-06-26. End date: 2025-07-04. Decision date: 2024-09-24. Results received: Yes. Last updated: 2025-04-15.
Decision dates by country: DE: 2024-09-26, ES: 2024-09-24, PL: 2024-09-25

Condition(s): Treatment-Resistant Depression (TRD)

Primary endpoint: CORE: Change from baseline in Montgomery-Asberg Depression Rating Scale (MADRS) for [CCI] mg compared to [CCI] mg of BPL-003 at [CCI], OLE: • Number of events and percentage of participants with TEAEs, OLE: • Percentage of participants with clinically significant abnormal laboratory tests compared to OLE and CORE baseline, OLE: • Percentage of participants with clinically significant abnormal vital sign measurements (heart rate, blood pressure, and body temperature) compared to OLE and CORE baseline, OLE: • Percentage of participants with clinically significant ECG parameters compared to OLE and CORE baseline, OLE: • Incidence of suicidal ideation or behavior, as assessed by the C-SSRS compared to OLE and CORE baseline
Endpoint(s): 1. Change from baseline in MADRS for [CCI] mg compared to [CCI] mg of BPL- 003 at [CCI], 2. Change from baseline in MADRS for [CCI] mg compared to [CCI] mg of BPL- 003 at [CCI], 3. Change from baseline in MADRS for [CCI] mg compared to [CCI] mg of BPL- 003 at [CCI], 4. Number of events and percentage of participants with treatment - emergent adverse events (TEAEs), 5. Percentage of participants with clinically significant abnormal laboratory tests compared to baseline, 6. Percentage of participants with clinically significant abnormal vital sign measurements (heart rate, blood pressure, and body temperature) compared to baseline, 7. Percentage of participants with clinically significant electrocardiogram (ECG) parameters compared to baseline, 8. Incidence of suicidal ideation or behavior, as assessed by the Columbia-Suicide Severity Rating Scale (C-SSRS) at [CCI] compared to baseline, 9. Impairment in cognitive performance, assessed by Cognitive Test Battery at [CCI] compared to baseline, 10. Plasma levels of 5-MeO-DMT and its metabolites (including bufotenine) up to [CCI] after nasal administration of BPL-003, 11. Change from baseline in MADRS for [CCI] mg and [CCI] mg of BPL-003 compared to [CCI] mg of BPL-003 at [CCI], 12. Percentage of responders (defined as 50% reduction in MADRS total score) at [CCI] compared to baseline, by dose group, 13. Percentage of participants in remission (defined as MADRS total score ≤ 10) at [CCI] by dose group, 14. Change in 16-item Quick Inventory of Depressive Symptomatology- Self-Report (QIDS-SR-16) score at [CCI] compared to baseline, by dose group, 15. Change in Quality of Life in Depression Scale (QLDS) score at [CCI] compared to baseline, by dose group, 16. Change in Sheehan Disability Scale (SDS) total score at [CCI] compared to baseline, by dose group, 17. Change in Clinical Global Impression-Severity (CGI-S) score at [CCI] compared to baseline, by dose group, OLE: 1. Change in MADRS compared to OLE and CORE baseline, OLE: 2. Percentage of responders (defined as 50% reduction in MADRS total score) compared to OLE and CORE baseline, OLE: 3. Percentage of participants in remission (defined as MADRS total score ≤ 10) compared to OLE and CORE baseline, OLE: 4. Plasma levels of 5-MeO-DMT and its metabolites (including bufotenine) up to [CCI] after nasal administration of BPL-003, OLE: 5. Change in QIDS-SR-16 score compared to OLE and CORE baseline, OLE: 6. Change in QLDS score compared to OLE and CORE baseline, OLE: 7. Change in SDS total score compared to OLE and CORE baseline, OLE: 8. Change in CGI-S score compared to OLE and CORE baseline

Source: https://euclinicaltrials.eu/ctis-public/view/2024-513457-70-00